EU clinical trial 2023-508515-23-00: A study to compare the amount of milvexian in blood when given as pediatric and adult tablet formulations, to assess the effect of food intake on the absorption of pediatric milvexian tablet formulation in healthy adult participants and to assess the acceptability of different milvexian formulations.
Sponsor: Janssen Cilag International (Pharmaceutical company). Phase: Human Pharmacology (Phase I)- Other. Countries: Belgium (ongoing, recruiting).
Therapeutic area(s): Diseases [C] - Cardiovascular Diseases [C14]
Gender: Female, Male. Age: 18-64 years. Enrolment: 56.
Status: Ongoing, recruiting. Start date (EU): 2024-03-19. Decision date: 2024-02-12. Results received: No. Last updated: 2025-03-27.

Condition(s): atherothrombotic and thromboembolic disorders

Source: https://euclinicaltrials.eu/ctis-public/view/2023-508515-23-00